EU clinical trial 2022-501480-41-00: An Open-Label Extension Study to Evaluate Long Term Safety and Efficacy of Tildrakizumab in Patients with Psoriatic Arthritis.
Protocol code: TILD-21-01
Sponsor: Sun Pharmaceutical Industries Limited (Pharmaceutical company). Phase: Therapeutic confirmatory (Phase III). Countries: Germany (ongoing, recruitment ended), Slovakia (ongoing, recruitment ended), Spain (ongoing, recruitment ended), Poland (ongoing, recruitment ended), Czechia (ongoing, recruitment ended), Estonia (ongoing, recruitment ended), Italy (ended).
Therapeutic area(s): Diseases [C] - Skin and Connective Tissue Diseases [C17]
Gender: Female, Male. Age: 18-64 years, 65+ years. Enrolment: 273.
Start date (EU): 2023-04-06. Decision date: 2023-02-20. Results received: No. Last updated: 2026-04-21.
Decision dates by country: IT: 2023-12-22, PL: 2023-03-01, CZ: 2023-05-30, EE: 2023-05-12, SK: 2023-02-20, ES: 2023-04-27, DE: 2023-02-23

Condition(s): Psoriatic Arthritis
Product: Ilumetri 100 mg solution for injection in pre-filled syringe

Primary endpoint: Safety - Incidence and intensity of adverse events recorded through the study period, Efficacy - Achieving ACR 20, ACR 50 and ACR 70

Source: https://euclinicaltrials.eu/ctis-public/view/2022-501480-41-00